EU clinical trial 2024-511838-12-00: Subcutaneous Tarlatamab in Subjects with Extensive Stage Small Cell Lung Cancer (DeLLphi-308)
Protocol code: 20230298
Sponsor: Amgen Inc. (Pharmaceutical company). Phase: Human Pharmacology (Phase I)- Other. Countries: Germany (ongoing, recruiting), Poland (ongoing, recruiting), Belgium (ongoing, recruiting), Spain (ongoing, recruiting).
Therapeutic area(s): Diseases [C] - Neoplasms [C04]
Gender: Female, Male. Age: 18-64 years, 65+ years. Enrolment: 86.
Status: Ongoing, recruiting. Start date (EU): 2024-11-22. Decision date: 2024-10-21. Results received: No. Last updated: 2026-06-09.
Decision dates by country: DE: 2024-10-22, BE: 2024-10-21, ES: 2024-10-28, PL: 2024-10-31

Condition(s): Extensive Stage Small Cell Lung Cancer (DeLLphi-308)

Source: https://euclinicaltrials.eu/ctis-public/view/2024-511838-12-00